EU clinical trial 2025-523774-16-00: A Multicenter, Open-label, Phase 1/2 Safety Run-in and Expansion Study of PM54 in Combination With Immunotherapy Evaluating Safety and Efficacy in Adult Participants who were Previously Treated for Advanced Malignancies
Protocol code: PM54-A-003-25
Sponsor: Pharma Mar S.A. (Pharmaceutical company). Phase: Phase I and Phase II (Integrated)- Other. Countries: Spain (authorised, recruiting).
Therapeutic area(s): Diseases [C] - Neoplasms [C04]
Gender: Female, Male. Age: 18-64 years, 65+ years. Enrolment: 36.
Status: Authorised, recruiting. Start date (EU): 2026-06-03. Decision date: 2026-04-24. Results received: No. Last updated: 2026-06-11.
Decision dates by country: ES: 2026-06-11

Condition(s): Advanced malignancies
Product: PEMBROLIZUMAB, PM54

Primary endpoint: Parts 1 and 2 Treatment-emergent adverse events (TEAEs), serious TEAEs, dose-limiting toxicities (DLTs), TEAEs leading to treatment discontinuation or dose modifications; these will be considered in the determination of the recommended dose (RD), Specific to Part 1 Only - DLTs during the DLT assessment period
Endpoint(s): Confirmed ORR per RECIST v1.1 (or mRECIST v1.1, where applicable) during the study, CBR in the first 12 weeks, Disease control rate, defined as the proportion of participants who achieve a best overall response of stable disease, PR, or CR as defined by RECIST v1.1 (or mRECIST v1.1, where applicable) during the study, Progression-free survival (PFS), Duration of response, Time to treatment failure, Overall survival, Plasma concentration of PM54 and pembrolizumab throughout the study

Source: https://euclinicaltrials.eu/ctis-public/view/2025-523774-16-00